EU clinical trial 2023-504737-41-00: A Randomized, Double-blind, Placebo-controlled, Parallel-group, Multicenter Study to Evaluate the Efficacy and Safety of Guselkumab Subcutaneous Induction Therapy in Participants with Moderately to Severely Active Crohn's Disease
Protocol code: CNTO1959CRD3004
Sponsor: Janssen - Cilag International (Pharmaceutical company). Phase: Therapeutic confirmatory (Phase III). Countries: Germany (ongoing, recruitment ended), Czechia (ongoing, recruitment ended), Spain (ended), Lithuania (ongoing, recruitment ended), Hungary (ongoing, recruitment ended), Poland (ongoing, recruitment ended), Italy (ended), Slovakia (ongoing, recruitment ended), Croatia (ongoing, recruitment ended), France (ended).
Therapeutic area(s): Diseases [C] - Immune System Diseases [C20]
Gender: Female, Male. Age: 18-64 years, 65+ years. Enrolment: 219.
Start date (EU): 2022-06-10. Decision date: 2024-07-18. Results received: No. Last updated: 2026-05-11.
Decision dates by country: IT: 2024-07-29, ES: 2024-07-19, LT: 2024-08-07, FR: 2024-07-29, HR: 2024-07-18, CZ: 2024-07-23, PL: 2024-08-04, SK: 2024-07-19, HU: 2024-07-18, DE: 2024-07-24

Condition(s): Moderately to Severely Active Crohn's Disease
Product: Placebo for Guselkumab, Guselkumab - solution for injection in pre-filled syringe - 100 mg/mL, Guselkumab

Primary endpoint: Clinical remission at Week 12, Endoscopic response at Week 12

Source: https://euclinicaltrials.eu/ctis-public/view/2023-504737-41-00